EU clinical trial 2023-503624-83-00: A Phase 1/2 Open-Label, Multicenter Study of INCB000928 Administered as a Monotherapy or in Combination With Ruxolitinib in Participants With Anemia Due to Myeloproliferative Disorders
Protocol code: INCB 00928-104
Sponsor: Incyte Corp. (Pharmaceutical company). Phase: Phase I and Phase II (Integrated)- Other. Countries: France (ended), Italy (ended).
Therapeutic area(s): Diseases [C] - Neoplasms [C04]
Gender: Female, Male. Age: 18-64 years, 65+ years. Enrolment: 90.
Status: Ended. Start date (EU): 2021-08-16. End date (EU): 2026-06-03. Decision date: 2024-09-05. Results received: No. Last updated: 2026-03-19.
Decision dates by country: FR: 2024-09-05, IT: 2024-09-10

Condition(s): Anaemia associated with myelofibrosis

Source: https://euclinicaltrials.eu/ctis-public/view/2023-503624-83-00